EU clinical trial 2025-521801-42-00: Implementation RSV Immunization Study (IRIS)
Protocol code: IIV-724
Sponsor: Rijksinstituut voor Volksgezondheid en Milieu (RIVM) (Hospital/Clinic/Other health care facility). Phase: Therapeutic use (Phase IV). Countries: Netherlands (ongoing, recruitment ended).
Therapeutic area(s): Diseases [C] - Virus Diseases [C02]; Diseases [C] - Respiratory Tract Diseases [C08]
Gender: Female, Male. Age: 0-17 years. Enrolment: 250.
Status: Ongoing, recruitment ended. Start date (EU): 2025-08-27. Decision date: 2025-07-21. Results received: No. Last updated: 2025-11-07.

Condition(s): Healthy infants receiving an RSV immunization to prevent for serious diseases due to an RSV infection
Product: Beyfortus 100 mg solution for injection in pre-filled syringe, Beyfortus 50 mg solution for injection in pre-filled syringe

Primary endpoint: RSV-specific antibody levels at 12 months post-nirsevimab immunization in the nirsevimab group and the control group (at 12-15 months of age)
Endpoint(s): RSV-specific serum IgA levels pre- and 2, 4, 6, 12 months post-nirsevimab immunization and in the control group, RSV-specific serum antibody levels pre- and 2, 4, 6 and 12 months post-nirsevimab immunization, RSV-specific serum antibody concentration pre- and 2, 4, 6 and 12 months postnirsevimab immunization / Questionnaire data such as age and weight of immunization, RSV-specific antibody neutralization and Fc-functionality at 12 months post immunization in the nirsevimab group and the control group, RSV-specific monoclonal and maternal antibody levels pre- and 2, 4, 6 and 12 months post-nirsevimab immunization

Source: https://euclinicaltrials.eu/ctis-public/view/2025-521801-42-00